EU clinical trial 2023-508091-11-00: Clinical efficacy and safety of sequential therapy with cryotherapy and topical tirbanibulin 1% in actinic keratoses in transplant recipients: a randomised clinical trial.
Protocol code: TIRTRASP
Sponsor: Clinica Universidad De Navarra (Hospital/Clinic/Other health care facility). Phase: Phase III and phase IV (Integrated). Countries: Spain (ended).
Therapeutic area(s): Diseases [C] - Skin and Connective Tissue Diseases [C17]
Gender: Female, Male. Age: 18-64 years, 65+ years. Enrolment: 40.
Status: Ended. Start date (EU): 2024-05-06. End date (EU): 2024-12-16. Decision date: 2024-03-27. Results received: Yes. Last updated: 2024-03-27.

Condition(s): Actinic keratosis
Product: Klisyri 10 mg/g ointment

Primary endpoint: The primary efficacy end point is the percentage change in the number of AKs on the side treated with cryotherapy + tirbanibulin at 3 months of follow-up, compared to the side treated with cryotherapy alone.
Endpoint(s): Percentage of patients with a complete response (100%) in the reduction in the number of lesions and a partial response (greater than or equal to 75%) in the reduction in the number of lesions in V(3) on the side treated with cryotherapy + tirbanibulin, compared to the side only treated with cryotherapy., Differences in the number of new and persistent AKs in V(3) between the area treated with cryotherapy + tirbanibulin and the area treated with cryotherapy alone., Number of local skin reactions and tolerance to treatment on each side., Differences in quality of life scales (comparing each side in V(3) with visit V(0), patient satisfaction and preference between both sides in V(3)., Description of persistent AKs according to Olsen grade (percentage of grade I, grade II and grade III).

Source: https://euclinicaltrials.eu/ctis-public/view/2023-508091-11-00